EU clinical trial 2024-515714-40-00: STING - Maintenance or withdrawal of urate lowering therapy according to ultrasound features in gout patients: a randomised controlled trial
Protocol code: APHP230854
Sponsor: Assistance Publique Hopitaux De Paris (Hospital/Clinic/Other health care facility). Phase: Therapeutic exploratory (Phase II). Countries: France (authorised, recruitment pending).
Therapeutic area(s): Diseases [C] - Nutritional and Metabolic Diseases [C18]
Gender: Female, Male. Age: 18-64 years, 65+ years. Enrolment: 450.
Status: Authorised, recruitment pending. Decision date: 2025-03-07. Results received: No. Last updated: 2026-04-08.

Condition(s): Gout adult patients
Product: FEBUXOSTAT, ALLOPURINOL

Primary endpoint: the proportion of patients experiencing one or more flares at two years (M24) according to the Gaffo’s criteria.
Endpoint(s): • The proportion of patients experiencing one or more flares at M6, M12, M18, M30 and M36 according to both the Gaffo's criteria and the patient-reported Gout Attack Intensity Score (GAIS), • Mean flare rates at M6, M12, M18, M24, M30, M36 according to both the Gaffo's criteria and the patient-reported Gout Attack Intensity Score (GAIS), • US features of gout at both MPT1s (double contour sign, tophi, aggregates) and both knees (double contour sign) at M6, M12, M18, M24, M30, M36 in the withdrawal arm and at M24 in the maintenance arm., • Urate levels at M6, M12, M18, M24, M30, M36, • Change from baseline to M6, M12, M18, M24, M30 and M36 in Outcome Measures in Rheumatology (OMERACT) core outcome domains for long-term gout studies: Pain (VAS 0–100 mm), patient’s global assessment of disease activity (VAS 0–100mm); Health-related quality of life using the EuroQol 5-domain-3L (EQ-5D-3L) questionnaire; Activity limitation using the Health Assessment Questionnaire II, • Incidence of Major CardioVascular events (nonfatal stroke, nonfatal myocardial infarction, cardiovascular death) at M6, M12, M18, M24, M30, M36, • Renal function (eGFR) at M6, M12, M18, M24, M30, M36, • Incidence of comorbidities at M6, M12,M18, M24,M30 and M36, • Overall Survival at M12, M24 and M36, • Consumption of colchicine, NSAIDs, steroids using a patient self-reported notebook at M6, M12, M18, M24, M30, M36, • Adverse events and serious adverse events at M6, M12, M18, M24, M30, M36 according to the CTCAE V5.0 classification, • Adherence to ULT by the questionnaire MARS at M6, M12, M18, M24, M30 and M36, • Incremental Cost effectiveness ratios estimating cost per QALY gained, • Incremental Cost effectiveness ratios estimating cost per flare avoided., Objective of any potential ancillary study: Blood samples for translational researches will be taken only from patients recruited at the Lariboisière centre at D0, M6, M12 and M24. The aim is to study the effects of the increase in urate levels on the innate immune system, the inflammatory pathways, particularly those involving monocytes, the proteome, the metabolome, the lipidome, the transcriptome and the epigenetic., • Agreement between the local and central reading of ultrasound features through the study period (M0 to M36): kappa value for the DC sign, tophi and aggregates at MTP1 and knees.

Source: https://euclinicaltrials.eu/ctis-public/view/2024-515714-40-00